EU clinical trial 2022-500906-17-01: INfluenza VaccInation To mitigate typE 1 Diabetes (INVITED trial)
Protocol code: INVITED-2022
Sponsor: Aarhus University Hospital (Hospital/Clinic/Other health care facility). Phase: Therapeutic exploratory (Phase II). Countries: Denmark (ongoing, recruiting).
Therapeutic area(s): Diseases [C] - Hormonal diseases [C19]
Gender: Female, Male. Age: 0-17 years. Enrolment: 100.
Status: Ongoing, recruiting. Start date (EU): 2023-03-21. Decision date: 2022-09-12. Results received: No. Last updated: 2026-01-28.

Condition(s): Type 1 diabetes
Product: Vaxigrip Tetra, suspension for injection in pre-filled syringe Quadrivalent influenza vaccine (split virion, inactivated), 0.9% sodium chloride for intra muscular injection from hospital stock

Primary endpoint: Change in fasting residual β cell (C-peptide) function, baseline to 12 months.
Endpoint(s): Change in fasting C-peptide levels, baseline to 6 months., Change in HbA1c, baseline to 12 months., Change in insulin requirements, baseline to 12 months (measured as total insulin dose per kg body weight per day as a mean for the last 14 days)., Time-In-Range (3.9-10.0 mmol/L) of continuous glucose monitoring over 14 days at 12 months., Percent coefficient of variation of glucose (%CV) over 14 days at 12 months.

Source: https://euclinicaltrials.eu/ctis-public/view/2022-500906-17-01